EU clinical trial 2025-523260-20-00: Protocol Title: Efficacy and safety of once-weekly subcutaneous NNC0662-0419 in participants with type 2 diabetes – a dose-finding study
Protocol code: NN9662-8160
Sponsor: Novo Nordisk A/S (Pharmaceutical company). Phase: Therapeutic exploratory (Phase II). Countries: Spain (ongoing, recruiting), Hungary (not authorised), Portugal (ongoing, recruiting), Poland (ongoing, recruiting), Slovakia (ongoing, recruiting), Croatia (ongoing, recruiting).
Therapeutic area(s): Diseases [C] - Hormonal diseases [C19]
Gender: Female, Male. Age: 18-64 years. Enrolment: 145.
Start date (EU): 2026-04-28. Decision date: 2026-04-21. Results received: No. Last updated: 2026-04-27.
Decision dates by country: HR: 2026-04-24, HU: 2026-04-21, PT: 2026-04-22, ES: 2026-04-27, PL: 2026-04-23, SK: 2026-04-21

Condition(s): type 2 diabetes
Product: Placebo A, Semaglutide B Placebo, Ozempic 0.5 mg solution for injection in pre-filled pen

Primary endpoint: Change in HbA1c
Endpoint(s): Relative change in body weight, Change in body weight

Source: https://euclinicaltrials.eu/ctis-public/view/2025-523260-20-00